EU clinical trial 2024-513598-33-00: Decrease of intraoperative fluid administration in cytoreductive surgery combined with hyperthermic intraperitoneal chemotherapy (CRS-HIPEC) with vasopressin (HiPRESS)
Sponsor: Het Nederlands Kanker Instituut-Antoni van Leeuwenhoek Ziekenhuis Stichting (Hospital/Clinic/Other health care facility). Phase: Therapeutic use (Phase IV). Countries: Netherlands (ongoing, recruiting).
Therapeutic area(s): Diseases [C] - Digestive System Diseases [C06]; Analytical,Diagnostic,Therapeutic Techniques and Equipment [E]-Surgical Procedures, Operative [E04]
Gender: Female, Male. Age: 18-64 years, 65+ years. Enrolment: 70.
Status: Ongoing, recruiting. Start date (EU): 2025-01-21. Decision date: 2024-11-11. Results received: No. Last updated: 2026-02-10.

Condition(s): Disseminated cancer
Product: Empressine 40 I.E./2ml, concentraat voor oplossing voor infusie

Primary endpoint: • Cumulative total intraoperative fluid (mL) administration at the end of the operation, including the amounts of crystalloids and blood products
Endpoint(s): • Cumulative total intraoperative fluid (mL/kg/h), • Postoperative fluid balance (mL), • Fluid balance at day 1 (mL), • Signs of fluid overload, assessed by Point-of-care ultrasound (POCUS, Appendix II) at day 0, 1 and 3., • Major complications as rated as Clavien Dindo score ≥2 up to postoperative day 30, • Abdominal complications up to day 30, • Pulmonary complications up to day 5, • Postoperative acute kidney injury as defined by the Kidney Disease Improving Global Outcomes definition (KDIGO) up to day 5, • Quality of recovery (QoR-15) at day 3, • Hospital and ICU length of stay, • 30-day mortality

Source: https://euclinicaltrials.eu/ctis-public/view/2024-513598-33-00